EU clinical trial 2023-509936-25-00: A multi-cohort, randomized, Phase 2, open-label study to assess the preliminary efficacy, safety, and pharmacokinetics of BIVV020 for prevention and treatment of antibody- mediated rejection in adult kidney transplant recipients
Protocol code: ACT17012
Sponsor: Sanofi-Aventis Recherche & Developpement (Pharmaceutical company). Phase: Therapeutic exploratory (Phase II). Countries: Sweden (ended), Germany (ongoing, recruitment ended), Spain (ended), France (ongoing, recruitment ended), Italy (ongoing, recruitment ended).
Therapeutic area(s): Diseases [C] - Immune System Diseases [C20]
Gender: Female, Male. Age: 18-64 years, 65+ years. Enrolment: 40.
Start date (EU): 2022-06-09. Decision date: 2024-06-12. Results received: No. Last updated: 2025-11-21.
Decision dates by country: SE: 2024-06-12, DE: 2024-06-14, ES: 2024-06-12, FR: 2024-06-17, IT: 2024-07-01

Condition(s): Transplant Rejection
Product: riliprubart, riliprubart

Primary endpoint: Cohort A: Treatment failure rate, Cohort B: AMR resolution rate
Endpoint(s): Cohort A: Treatment failure rate, Cohort B: AMR resolution rate, Change in renal function from baseline per central laboratory assessment of estimated glomerular filtration rate (eGFR) from serum creatinine using Modification of Diet in Renal Disease equation (MDRD), Change in renal function from baseline per central laboratory assessment using protein: creatinine ratio, Change in allograft histopathology Banff score, Graft survival as predicted by iBOX, Assessment of adverse events (AEs), Change in systemic lupus erythematosus (SLE) panel, Plasma exposure of BIVV020 assessing pharmacokinetic parameter Cmin, Plasma exposure of BIVV020 assessing pharmacokinetic parameter AUC, Number of participants with anti-BIVV020 antibodies

Source: https://euclinicaltrials.eu/ctis-public/view/2023-509936-25-00